EU clinical trial 2023-503928-10-00: A Phase II, Randomized, Double-Blind, Placebo-Controlled, Dose-Finding Study to Evaluate the Safety, Biomarkers, and Efficacy of Tominersen in Individuals with Prodromal and Early Manifest Huntington’s Disease
Protocol code: BN42489
Sponsor: F. Hoffmann-La Roche AG (Pharmaceutical company). Phase: Therapeutic exploratory (Phase II). Countries: Poland (ongoing, recruitment ended), Germany (ongoing, recruitment ended), Portugal (ongoing, recruitment ended), Denmark (ongoing, recruitment ended), France (ongoing, recruitment ended), Austria (ongoing, recruitment ended), Italy (ongoing, recruitment ended), Spain (ongoing, recruitment ended).
Therapeutic area(s): Diseases [C] - Nervous System Diseases [C10]; Not possible to specify
Gender: Female, Male. Age: 18-64 years. Enrolment: 162.
Status: Ongoing, recruitment ended. Start date (EU): 2023-02-01. Decision date: 2024-05-17. Results received: No. Last updated: 2026-07-13.
Decision dates by country: FR: 2024-05-24, PL: 2024-05-27, DE: 2024-05-22, IT: 2024-05-22, DK: 2024-05-20, PT: 2024-05-17, AT: 2024-05-22, ES: 2024-05-22

Condition(s): Prodromal and Early Manifest Huntington’s Disease
Product: RO7234292, RO7234292 Placebo

Primary endpoint: Incidence and severity of adverse events, with severity determined according to the Adverse Event Severity Grading Scale (DB Period), Change from baseline in clinical laboratory results (CSF WBC and protein) (DB Period), Safety MRI (DB Period), Percentage change from baseline in geometric means of CSF mHTT protein levels at Month 9 (DB Period), Change from baseline in cUHDRS (non-U.S.) and TFC (U.S.) at 16 months (DB Period), Incidence and severity of adverse events, with severity determined according to the Adverse Event Severity Grading Scale (OLE Period), Change over time in clinical laboratory results (CSF, WBC, and protein) (OLE period), Safety MRI (OLE period)
Endpoint(s): Change from baseline in vital signs (DB period), Change from baseline in ECG parameters (DB period), Change from baseline in plasma clinical laboratory results (DB period), Change from baseline in MoCA (DB period), Proportion of participants with suicidal ideation or behavior as assessed by C-SSRS score at each visit, including detailed focus on any individual cases identified as having severe ideation or behavior during the study conduct (DB period), Change from baseline at 16 months for the assessments of TFC (non-U.S.)/cUHDRS (U.S.), SDMT, TMS, and SWR (DB period), Change from baseline in CSF NfL levels at 16 months (DB period), Incidence of anti-drug antibodies (ADAs) at specified timepoints relative to the prevalence of ADAs at baseline (DB period), Titers will be determined if ADAs are identified (DB period), Change over time in cUHDRS, TFC, SDMT, TMS, SWR (OLE period), Change over time in vital signs (OLE period), Change over time in ECG parameters (OLE period), Change over time in plasma clinical laboratory results (OLE period), Change over time in MoCA (OLE period), Proportion of participants with suicidal ideation or behavior as assessed by C-SSRS score at each visit, including detailed focus on any individual cases identified as having severe ideation or behavior during the study conduct (OLE period), Incidence of ADAs at specified timepoints (OLE period)

Source: https://euclinicaltrials.eu/ctis-public/view/2023-503928-10-00